EU clinical trial 2025-520487-18-00: Adaptive phase II randomized non-comparative trial of nivolumab after induction treatment in triple-negative breast cancer (TNBC) patients: TONIC-trial
Protocol code: N15TON
Sponsor: Het Nederlands Kanker Instituut-Antoni van Leeuwenhoek Ziekenhuis Stichting (Hospital/Clinic/Other health care facility). Phase: Therapeutic exploratory (Phase II). Countries: Netherlands (ongoing, recruitment ended).
Therapeutic area(s): Diseases [C] - Neoplasms [C04]
Gender: Female, Male. Age: 18-64 years, 65+ years. Enrolment: 84.
Status: Ongoing, recruitment ended. Start date (EU): 2015-09-08. Decision date: 2025-01-24. Results received: No. Last updated: 2025-01-24.

Condition(s): Triple negative breast cancer (TNBC) patients with metastatic disease
Product: OPDIVO 10 mg/mL concentrate for solution for infusion.

Primary endpoint: Progression-free survival (=PFS1, time from randomization to tumor progression or death from any cause). Progression as defined by RECIST 1.1 will be used.
Endpoint(s): Progression-free survival (=PFS1, time from randomization to tumor progression or death from any cause). Progression as defined by modified RECIST 1.1 for immune-based therapeutics (iRECIST) will be used., Progression-free survival (=PFS2, time from nivolumab treatment initiation to tumor progression). Progression as defined by RECIST 1.1 and iRECIST will be used., Overall response rate ORR (complete response CR or partial response PR) according to RECIST 1.1 and iRECIST. ORR1 (relative to randomization) and ORR2 (relative to nivolumab initiation) will be used., Clinical benefit rate (CR+PR+stable disease ≥ 6 months and CR+PR+stable disease ≥ 3 months) according to RECIST 1.1 and iRECIST. CBR1 (relative to randomization) and CBR2 (relative to nivolumab initiation) will be used., Overall survival (OS, time from nivolumab initiation to death from any cause)., Percentage of patients with toxicity (classified according to CTCAE v4.0) and immune-related toxicity.

Source: https://euclinicaltrials.eu/ctis-public/view/2025-520487-18-00